EU clinical trial 2024-513445-37-00: A prospective, open-label, randomized, multicenter phase-III trial to evaluate the efficacy of pirtobrutinib and epcoritamab compared with R-(mini)-CHOP for treatment of patients with Richter Transformation - CLLRT2
Protocol code: CLLRT2
Sponsor: University Of Cologne (Educational Institution). Phase: Therapeutic confirmatory (Phase III). Countries: Austria (authorised, recruiting), Germany (ongoing, recruiting), Denmark (authorised, recruitment pending), Ireland (authorised, recruitment pending).
Therapeutic area(s): Diseases [C] - Neoplasms [C04]
Gender: Female, Male. Age: 18-64 years, 65+ years. Enrolment: 57.
Start date (EU): 2026-06-08. Decision date: 2026-03-18. Results received: No. Last updated: 2026-03-30.
Decision dates by country: AT: 2026-03-30, DK: 2026-03-18, DE: 2026-03-18, IE: 2026-03-27

Condition(s): previously untreated RT, irrespective of risk factors and disease stage
Product: Caelyx pegylated liposomal 2 mg/ml concentrate for solution for infusion, Jaypirca 100 mg film-coated tablets, EPCORITAMAB, PREDNISOLONE, EPCORITAMAB, VINCRISTINE, CYCLOPHOSPHAMIDE, MabThera 100 mg concentrate for solution for infusion

Primary endpoint: Investigator-assessed progression-free survival (PFS) according to Lugano criteria
Endpoint(s): Overall response rate (ORR; assessed by Lugano), Complete response rate (CRR; assessed by Lugano guidelines) at the end of (combination) treatment [EO(C)T], Best response (assessed by Lugano), Undetectable minimal residual disease (uMRD) rate in peripheral blood at EO(C)T, Duration of response (DOR) according to Lugano criteria, Overall survival (OS), Time-to-next treatment (TTNT), Treatment-free survival (TFS), Proportion of patients receiving allogeneic stem cell transplantation (SCT) for consolidation

Source: https://euclinicaltrials.eu/ctis-public/view/2024-513445-37-00